EU clinical trial 2025-524791-30-00: PET imaging For eaRly predictiOn of respoNse to neoadjuvanT tReatment in lUNg caNcER
Sponsor: Radboud universitair medisch centrum Stichting (Hospital/Clinic/Other health care facility). Phase: Phase I and Phase II (Integrated)- Other. Countries: Netherlands (authorised, recruitment pending), Germany (authorised, recruitment pending).
Therapeutic area(s): Diseases [C] - Respiratory Tract Diseases [C08]
Gender: Female, Male. Age: 18-64 years, 65+ years. Enrolment: 40.
Status: Authorised, recruitment pending. Decision date: 2026-06-29. Results received: No. Last updated: 2026-07-03.
Decision dates by country: DE: 2026-07-03, NL: 2026-06-30

Condition(s): Non small cell lung cancer

Source: https://euclinicaltrials.eu/ctis-public/view/2025-524791-30-00